EU clinical trial 2024-515044-23-01: Dapagliflozin in patients with Right Heart Failure (Dapa-RHF)
Protocol code: 2021-01755
Sponsor: Universitaetsmedizin Goettingen (Hospital/Clinic/Other health care facility). Phase: Therapeutic exploratory (Phase II). Countries: Germany (ongoing, recruiting).
Therapeutic area(s): Diseases [C] - Cardiovascular Diseases [C14]
Gender: Female, Male. Age: 18-64 years, 65+ years. Enrolment: 30.
Status: Ongoing, recruiting. Start date (EU): 2024-04-29. Decision date: 2024-08-30. Results received: No. Last updated: 2024-08-30.

Condition(s): Chronic right heart failure
Product: Dapagliflozin Placebo tablets, DAPAGLIFLOZIN

Primary endpoint: Change in serum NT-proBNP level from baseline to end of treatment (Delta-NTproBNP)
Endpoint(s): Change in quality of life assessed by overall summary score of the Kansas City Cardiomyopathy Questionnaire (KCCQ) (a specific HF patient reported outcome questionnaire) from baseline to end of treatment, Change in RV ejection fraction (RV EF) [%] assessed in cardiac MRI from baseline to end of treatment, Change in exercise capacity assessed by the 6 min walking distance [meters] from baseline to end of treatment, Change in NYHA (New York Heart Association) class from baseline to end of treatment

Source: https://euclinicaltrials.eu/ctis-public/view/2024-515044-23-01